EU clinical trial 2025-524418-27-00: A Phase 1/2, dose escalation and expansion study of TRI-611, an oral ALK molecular glue degrader in participants with advanced ALK-positive NSCLC
Protocol code: TRI-611-101
Sponsor: Triana Biomedicines Inc. (Pharmaceutical company). Phase: Phase I and Phase II (Integrated)- First administration to humans. Countries: France (authorised, recruitment pending), Italy (authorised, recruitment pending), Germany (authorised, recruitment pending), Spain (authorised, recruitment pending).
Therapeutic area(s): Diseases [C] - Respiratory Tract Diseases [C08]
Gender: Female, Male. Age: 18-64 years, 65+ years. Enrolment: 4.
Status: Authorised, recruitment pending. Decision date: 2026-07-22. Results received: No. Last updated: 2026-07-24.
Decision dates by country: FR: 2026-07-22, DE: 2026-07-23, IT: 2026-07-23, ES: 2026-07-24

Condition(s): Advanced ALK-positive NSCLC
Product: TRI-611, TRI-611

Primary endpoint: 1. Overall safety profile as assessed by the type, frequency, severity, timing, and relationship to investigational medicinal product (IMP) of adverse events (AEs), including dose-limiting toxicity (DLT) rate, and changes in vital signs, electrocardiograms (ECGs), and safety laboratory tests, 2. ORR and DofR
Endpoint(s): 1.1 Summary of TRI-611 plasma PK parameters, including half-life (t1/2), AUC, maximum observed plasma concentration (Cmax), and minimum observed plasma concentration (Cmin) after a single and multiple oral doses, 1.2 Objective response rate (ORR), duration of response (DOR), disease control rate (DCR), clinical benefit rate (CBR), depth of response (DofR), PFS, overall survival (OS), 1.3 CNS ORR, DOR, time to intracranial progression, 1.4 Profile changes in ALK protein levels in tumor sample on treatment vs at baseline, 2.1 Safety profile as assessed by the type, frequency, severity, timing, and relationship to IMP for AEs, and changes in vital signs, ECGs, and safety laboratory tests, 2.2 DOR, DCR, CBR, PFS, OS, 2.3 CNS ORR, DOR, time to intracranial progression

Source: https://euclinicaltrials.eu/ctis-public/view/2025-524418-27-00